EU clinical trial 2024-511965-13-00: A Phase 1b Study of Neoadjuvant Xaluritamig in Subjects With Newly Diagnosed Localized Intermediate or High-Risk Prostate Cancer
Protocol code: 20230237
Sponsor: Amgen Inc. (Pharmaceutical company). Phase: Human Pharmacology (Phase I)- Other. Countries: Germany (ongoing, recruitment ended).
Therapeutic area(s): Diseases [C] - Neoplasms [C04]
Gender: Male. Age: 18-64 years. Enrolment: 12.
Status: Ongoing, recruitment ended. Start date (EU): 2026-07-03. Decision date: 2024-10-18. Results received: No. Last updated: 2026-07-02.

Condition(s): Newly diagnosed localized Intermediate or High‐Risk Prostate Cancer

Source: https://euclinicaltrials.eu/ctis-public/view/2024-511965-13-00